EU clinical trial 2025-521240-37-00: A Randomized, Parallel-Group, Double-Blind, Placebo-Controlled, Monotherapy Study of the Efficacy, Safety, and Tolerability of SPT-300 in Adults with Major Depressive Disorder (MDD), with or without Anxious Distress
Protocol code: SPT-300-2024-203
Sponsor: Seaport Therapeutics Inc. (Pharmaceutical company). Phase: Therapeutic exploratory (Phase II). Countries: Bulgaria (ongoing, recruiting), Slovakia (ongoing, recruiting), Czechia (ongoing, recruiting), Germany (ongoing, recruiting), Hungary (ongoing, recruiting), Romania (ended), Poland (ongoing, recruiting).
Therapeutic area(s): Psychiatry and Psychology [F] - Mental Disorders [F03]
Gender: Female, Male. Age: 18-64 years, 65+ years. Enrolment: 273.
Start date (EU): 2025-09-11. Decision date: 2025-08-04. Results received: No. Last updated: 2026-06-01.
Decision dates by country: RO: 2025-08-11, CZ: 2025-08-04, HU: 2025-08-07, PL: 2025-08-11, SK: 2025-08-04, BG: 2025-08-07, DE: 2025-08-05

Condition(s): Major Depressive Disorder (MDD), with or without Anxious Distress
Product: Placebo for SPT-300

Primary endpoint: Change from Baseline to Visit 6 (Study Day 42) in Hamilton Depression Rating Scale-17 (HAM-D-17) total score
Endpoint(s): Change from Baseline to Visit 6 (Study Day 42) in Clinician Global Impression-Severity (CGI-S)

Source: https://euclinicaltrials.eu/ctis-public/view/2025-521240-37-00